EU clinical trial 2023-505567-37-00: Phase II-III study to assess the efficacy and safety of sublingual immunotherapy in patients suffering from birch pollen allergy
Sponsor: ROXALL Medizin GmbH (Pharmaceutical company). Phase: Phase II and Phase III (Integrated). Countries: Germany (ended).
Therapeutic area(s): Diseases [C] - Immune System Diseases [C20]
Gender: Female, Male. Age: 18-64 years. Enrolment: 30.
Status: Ended. Start date (EU): 2023-08-22. End date (EU): 2024-10-11. End date: 2024-10-12. Decision date: 2023-08-22. Results received: No. Last updated: 2023-08-22.

Condition(s): Moderate-to-severe allergic rhinitis / rhinoconjunctivitis due to birch pollen for at least two years according to the Allergic Rhinitis and its Impact on Asthma (ARIA) guideline
Product: Provokationstest Birkenpollen LETI, 30 HEP/ml Pulver, Lösungsmittel und Verdünnungsmittel zur Herstellung einer Provokationstestlösung, SULGEN® Spray Betula verrucosa low dose, ALK-prick Positiv-Kontrolle ist ein Histaminpräparat für die Pricktestung., MometaHEXAL 50 Mikrogramm/Sprühstoß Nasenspray, Suspension, ALK-prick SQ - 503 Milbe Dermatophagoides pteronyssinus, 10 HEP, Lösung für den Pricktest, PRICK TEST Beifuss LETI, 30 HEP/ml Pricktestlösung., SULGEN® Spray Betula verrucosa high dose, Sublingual placebo preparation with appearance, smell, taste and excipients identical to verum, but without the active substance, i. e. allergen extract., ALK-prick SQ - 312 Beifuß - 10 HEP - Lösung für den Pricktest, Lorano akut, 10 mg Tabletten, Prick Test LETI Negativkontrolle Pricktestlösung, ALK-prick SQ - 225 Wiesenlieschgras - 10 HEP - Lösung für den Pricktest, ALK-prick SQ 553 Hundehaare 10 HEP Lösung für den Pricktest, PRICK TEST Alternaria alternata LETI, 30 HEP/ml Pricktestlösung., ALK-prick Negativ-Kontrolle Pricktestlösung, PRICK TEST Birkenpollen LETI, 30 HEP/ml Pricktestlösung., PRICK TEST Hundeepithel LETI, 30 HEP/ml Pricktestlösung., PRICK TEST Gräser-Mix LETI, 30 HEP/ml Pricktestlösung., ALK-prick N - 302 Ragweed (Ambrosia) - 1:100 G/V - Lösung für den Pricktest, PRICK TEST Dermatophagoides pteronys- sinus LETI, 100 HEP/ml Pricktestlösung., SULGEN® Spray Betula verrucosa mid dose, ALK-prick SQ - 555 Katzenhaare - 10 HEP - Lösung für den Pricktest, PRICK TEST Katzenepithel LETI, 30 HEP/ml Pricktestlösung., Prick Test Histamin LETI Positivkontrolle 10 mg/ml Pricktestlösung, Prednisolon 10 mg JENAPHARM®, ALK-prick SQ - 108 Birke - 10 HEP - Lösung für den Pricktest, ALK-prick N - 402 Alternaria alternata (tenuis) - 1:20 G/V - Lösung für den Pricktest

Primary endpoint: The primary (efficacy) endpoint is defined as the absolute differences in mean CSMS (Combined Symptom and Medication Score) during Peak Birch Pollen Period (PBPP) of each active treatment group compared to placebo treatment group.
Endpoint(s): Absolute and relative differences in mean CSMS during Birch Pollen Season (BPS) between active and placebo treatment groups., Absolute and relative differences in mean dSS during PBPP and BPS., Absolute and relative differences in mean dMS during PBPP and BPS, Global Rhinoconjunctivitis Discomfort with a Visual Analogue Scale (VAS), Change in Rhinoconjunctivitis quality of life questionnaire (RQLQ) between active and placebo treatment groups comparing basal and post-treatment scoring, Well and severe days: A well day is defined as a day without administration of any rescue medication (dMS = 0) and with dSS < 0.34 (range 0-3). A severe day is defined (acc. to Pfaar et al. 2014a) as a day with a single score = 3 in any of the six symptoms. Percentages of well and severe days will be calculated for each subject as the number of well or severe days in the PBPP and BPS in relation to the number of days comprising both periods., Symptom-free days are defined as the days with absence of symptoms (dSS = 0) and without administration of any rescue medication (dMS = 0), expressed as percentage of days during the PBPP and BPS., tNPT titrated Nasal Provocation Test: To assess the efficacy of each dose of SULGEN® Spray Betula verrucosa compared to placebo. Defined as percentage of patients with an increased dosing step and the change in number of dosing steps needed to provoke a positive response in the titrated nasal provocation test (tNPT) post-treatment compared with pre-treatment (i. e. any improvement) in each of the four treatment groups. This is based on the change of the response to nasal provocation (tNPT) with, To analyse the safety and tolerability of each dose of SULGEN® Spray Betula verrucosa compared to placebo by Treatment-Emergent Adverse Drug Reactions (TEADR) and patients affected with TEADRs in each group

Source: https://euclinicaltrials.eu/ctis-public/view/2023-505567-37-00